EU clinical trial 2023-510536-37-00: A multicenter, open label, randomized phase II trial to evaluate the efficacy of Talazoparib plus Enzalutamide as first line treatment for patients with Metastatic castration resistant Prostate Cancer after progression to an Androgen Receptor Pathway Inhibitor
Protocol code: TEAM PC
Sponsor: Fundacion Oncosur (Laboratory/Research/Testing facility). Phase: Therapeutic exploratory (Phase II). Countries: Spain (ongoing, recruiting), France (ongoing, recruiting).
Therapeutic area(s): Diseases [C] - Neoplasms [C04]; Diseases [C] - Male Urogenital Diseases [C12]
Gender: Male. Age: 18-64 years, 65+ years. Enrolment: 103.
Status: Ongoing, recruiting. Start date (EU): 2024-07-05. Decision date: 2024-06-05. Results received: No. Last updated: 2026-06-09.
Decision dates by country: ES: 2024-06-05, FR: 2025-08-18

Condition(s): Prostate Cancer
Product: ENZALUTAMIDE, ENZALUTAMIDE, Talzenna 0.1 mg hard capsules, Talzenna 0.25 mg hard capsules

Primary endpoint: PSA response: percentage of patients with PSA decline ≥ 50% from baseline PSA value at 12-16 weeks and/or, Objective response rate: percentage of patients with radiographic response (partial or complete) during the first 16 weeks on follow up as per investigator assessment of soft tissue/visceral disease per RECIST 1.1, in subjects with measurable lesions.
Endpoint(s): Radiographic progression free survival (rPFS), based on RECIST v1.1 and/or PCGW3 guidelines, Time to PSA progression (TTPP), based on PCGW3 guidelines., Time to unequivocal clinical progression (TTCP), based on PCGW3 guidelines, Incidence of adverse events (AEs), based on CTCAE v.5.0 criteria

Source: https://euclinicaltrials.eu/ctis-public/view/2023-510536-37-00